EU clinical trial 2025-521624-30-00: A Phase 2, Parallel-arm, Randomized, Double-blind, Placebo-controlled, Dose-ranging Study to Evaluate the Efficacy and Safety of BFB759 in Patients with Atopic Dermatitis (COMPASS 2-AD)
Protocol code: CL-BFB759-002
Sponsor: Bluefin Biomedicine Inc. (Pharmaceutical company). Phase: Therapeutic exploratory (Phase II). Countries: Poland (ongoing, recruitment ended), Bulgaria (ongoing, recruitment ended), Germany (ongoing, recruitment ended), Czechia (ongoing, recruitment ended), Spain (ongoing, recruitment ended).
Therapeutic area(s): Diseases [C] - Skin and Connective Tissue Diseases [C17]; Diseases [C] - Immune System Diseases [C20]
Gender: Female, Male. Age: 18-64 years, 65+ years. Enrolment: 88.
Status: Ongoing, recruitment ended. Start date (EU): 2026-01-08. Decision date: 2025-10-31. Results received: No. Last updated: 2026-06-10.
Decision dates by country: DE: 2025-10-31, BG: 2025-11-05, ES: 2025-11-04, PL: 2025-11-04, CZ: 2025-11-04

Condition(s): Atopic dermatitis
Product: BFB759, Placebo

Primary endpoint: Percent change from baseline at Week 16 in EASI (Eczema Area and Severity Index) for Active 1 and Active 2 groups compared to Placebo
Endpoint(s): Analysis (Active 1 and Active 2 compared to Placebo): Proportion of participants meeting criteria for EASI75 defined as at least a 75% decrease in EASI score at Week 16 relative to baseline, Proportion of participants meeting criteria for EASI50 defined as at least a 50% decrease in EASI score at Week 16 relative to baseline, Proportion of participants meeting criteria for EASI90 defined as at least a 90% decrease in EASI score at Week 16 relative to baseline, Changes from baseline in Body Surface Area (BSA) at Week 16, Changes from baseline in SCORing Atopic Dermatitis (SCORAD) at Week 16, Changes from baseline in the validated Investigator’s Global Assessment for Atopic Dermatitis (vIGA-AD) at Week 16, Proportion of participants meeting the criteria of a vIGA-AD response of 0 or 1 at Week 16 relative to baseline, Changes from baseline in the weekly average Itch Numerical Rating Scale (NRS) at Week 16, Proportion of participants with ≥ 4-point decrease in weekly average Itch NRS in participants with a weekly average Itch NRS ≥ 4 at baseline at Week 16 relative to baseline, Safety and tolerability will be assessed by the incidence and severity of treatment emergent adverse events (TEAEs) (described by Common Terminology Criteria for Adverse Events [CTCAE] Version 5.0)

Source: https://euclinicaltrials.eu/ctis-public/view/2025-521624-30-00